EU clinical trial 2023-508318-41-00: A Phase I/II Combination Study of NMS-03305293 and Temozolomide in Adult Patients with Recurrent Glioblastoma
Protocol code: PARPA-293-002
Sponsor: Nerviano Medical Sciences S.r.l. (Pharmaceutical company). Phase: Phase I and Phase II (Integrated)- Other. Countries: Netherlands (ended), Italy (temporarily halted).
Therapeutic area(s): Diseases [C] - Neoplasms [C04]
Gender: Female, Male. Age: 18-64 years, 65+ years. Enrolment: 36.
Start date (EU): 2021-09-30. Decision date: 2023-12-07. Results received: No. Last updated: 2024-11-13.
Decision dates by country: NL: 2023-12-07, IT: 2023-12-14

Condition(s): Recurrent Glioblastoma
Product: Temozolomide SUN 140 mg hard capsules, Temozolomide SUN 20 mg hard capsules, Temozolomide SUN 5 mg hard capsules

Primary endpoint: First cycle Dose Limiting Toxicities (DLTs) (Phase I), Objective Response Rate (ORR), calculated as the proportion of evaluable patients who have achieved, as best overall response (BOR), confirmed complete response (CR) or partial response (PR) through central retrospective assessment of RANO criteria (Phase II)
Endpoint(s): Overall safety profile of the combination of NMS-03305293 and TMZ characterized by type, frequency, severity (graded using the NCI CTCAE Version 5.0), duration of adverse events (AEs), ECGs and laboratory abnormalities, and relationship of AEs to the study treatment, Plasma pharmacokinetic profile of NMS-03305293 and possible identified metabolites (if appropriate) after oral administration, Renal clearance and fraction of NMS-03305293 and possible identified metabolites (if appropriate) excreted in urine, Secondary efficacy endpoints Phase I: -Objective Tumor Response (Partial and Complete Response) (RANO criteria) - Duration of response (DoR) - Progression-free survival (PFS) - Overall survival (OS), Secondary efficacy endpoints Phase II: - Duration of response (DoR) through central retrospective assessment of RANO criteria - Progression-free survival (PFS) and 6-month PFS rate - 9 and 12-month overall survival rates - Overall survival (OS)

Source: https://euclinicaltrials.eu/ctis-public/view/2023-508318-41-00